EU clinical trial 2023-505449-18-00: HOVON 159 CLL: REtreatment with VEnetoclax and Acalabrutinib after venetoclax Limited duration (REVEAL) A prospective, multicenter, phase-II trial of venetoclax plus acalabrutinib in patients who have relapsed after first line venetoclax + anti-CD20 mAb treatment for chronic lymphocytic leukemia (CLL or SLL)
Protocol code: HO159
Sponsor: Haemato Oncology Foundation For Adults Netherlands (Hospital/Clinic/Other health care facility). Phase: Therapeutic exploratory (Phase II). Countries: Belgium (ongoing, recruiting), Netherlands (ongoing, recruiting), Denmark (ongoing, recruiting).
Therapeutic area(s): Diseases [C] - Hemic and Lymphatic Diseases [C15]
Gender: Female, Male. Age: 18-64 years, 65+ years. Enrolment: 60.
Status: Ongoing, recruiting. Start date (EU): 2020-07-23. Decision date: 2024-11-11. Results received: No. Last updated: 2026-06-05.
Decision dates by country: DK: 2024-11-12, BE: 2024-11-14, NL: 2024-11-11

Condition(s): Patients with relapsed CLL, Chronic lymphocytic leukemia
Product: Acalabrutinib, Venetoclax, Venetoclax, Venetoclax

Primary endpoint: uMRD in bone marrow (BM) by flow cytometry after 26 cycles
Endpoint(s): Depth of MRD measured in BM after cycle 13 and 26, Depth of MRD measured in PB after cycle 8, 10, 13, 16, 19, 22, 26 and every 3-6 months thereafter, Best overall response rate (ORR) defined as the proportion of subjects with a complete response (CR), complete response with incomplete marrow recovery (CRi), or partial response (PR) according to IWCLL 2018 criteria, Progression free survival (PFS), defined as time from registration to the first occurrence of disease progression or death from any cause (whichever occurs first)., Event free survival (EFS), defined as time from registration to date start of first CLL treatment off protocol, progression or death, whichever comes first, Overall survival (OS), defined as the time from registration to death from any cause, Treatment free interval (TFI), defined as date of last protocol treatment to start date of first CLL treatment off protocol, or death from any cause whichever comes first, Incidence and severity of AEs, with severity determined according to NCI CTCAE v5.0, Exploratory: Depth of MRD by different techniques (flow cytometry, circulating tumor DNA (ctDNA), next-generation sequencing), Exploratory: TruCulture and flow cytometry for immune subsets and function, Exploratory: Grading of hematological toxicity according to IWCLL20, Exloratory: Disease-related symptoms and health-related quality of life (HRQoL) measured by following questionnaires: EORTC QLQ-C30, EORTC QLQCLL17 and PRO-CTCAE

Source: https://euclinicaltrials.eu/ctis-public/view/2023-505449-18-00